EU clinical trial 2025-521551-23-01: Sequential Chemotherapy regimen with vinorelbine and cisplatin plus PET-guided stereotactic ablative radiotherapy (SABR) for castration- and taxane-resistant Prostate cancer (ChemSABR Prostate)
Sponsor: Tartu University Hospital (Hospital/Clinic/Other health care facility). Phase: Phase I and Phase II (Integrated)- Other. Countries: Estonia (authorised, recruitment pending).
Therapeutic area(s): Diseases [C] - Male Urogenital Diseases [C12]; Diseases [C] - Neoplasms [C04]
Gender: Male. Age: 18-64 years, 65+ years. Enrolment: 80.
Status: Authorised, recruitment pending. Decision date: 2025-06-26. Results received: No. Last updated: 2025-06-26.

Condition(s): prostate cancer
Product: CISPLATIN, VINORELBINE

Primary endpoint: Safety is the primary outcome measure in Phase I of this study, PFS is the primary outcome measure in Phase II.

Source: https://euclinicaltrials.eu/ctis-public/view/2025-521551-23-01